EU clinical trial 2023-505769-98-00: Open label, single-center, cross-over randomized, relative bioavailability study comparing 4 new BF2.649 (pitolisant) tablet formulations versus the reference pitolisant (Wakix®) tablet formulation after single oral administrations in healthy male subjects.
Protocol code: P22-06
Sponsor: Bioprojet Pharma (Pharmaceutical company). Phase: Human Pharmacology (Phase I)- Other. Countries: Belgium (ended).
Therapeutic area(s): Diseases [C] - Nervous System Diseases [C10]
Gender: Male. Age: 18-64 years. Enrolment: 16.
Status: Ended. Start date (EU): 2023-09-26. End date (EU): 2024-01-03. Decision date: 2023-08-17. Results received: Yes. Last updated: 2023-10-10.

Condition(s): Narcolepsy, Narcolepsy with cataplexy
Product: Wakix 18 mg film-coated tablets

Primary endpoint: PK parameters of pitolisant and main identified metabolites
Endpoint(s): safety and tolerance

Source: https://euclinicaltrials.eu/ctis-public/view/2023-505769-98-00